EU clinical trial 2023-510567-35-00: MegaMOST - A multicenter, open-label, biology driven, Phase II study evaluating the activity of anti-cancer treatments targeting tumor molecular alterations/characteristics in advanced / metastatic tumors
Protocol code: ET19-073
Sponsor: Centre Leon Berard (Hospital/Clinic/Other health care facility). Phase: Therapeutic exploratory (Phase II). Countries: France (ongoing, recruiting).
Therapeutic area(s): Diseases [C] - Neoplasms [C04]
Gender: Female, Male. Age: 18-64 years, 65+ years. Enrolment: 455.
Status: Ongoing, recruiting. Start date (EU): 2020-06-10. Decision date: 2024-09-13. Results received: No. Last updated: 2026-07-16.

Condition(s): Advanced / metastatic cancers
Product: AVAPRITINIB, HDM201, REGORAFENIB, RIBOCICLIB, HDM201, ALECTINIB, DABRAFENIB, TRAMETINIB, CABOZANTINIB

Primary endpoint: Progression free rate after 3 months of treatment (3M-PFR). (12 weeks)
Endpoint(s): Objective response rate after 3 months of treatment (3M-ORR), Duration of Response (DoR), Progression Free Survival (PFS), Overall survival (OS), Percentage of long-term responders (> 6 months)

Source: https://euclinicaltrials.eu/ctis-public/view/2023-510567-35-00